EU clinical trial 2024-510818-33-00: A multicenter, double-blind, placebo-controlled, randomized withdrawal and open-label extension study followed by long-term open-label treatment cycles to assess the efficacy, safety and tolerability of remibrutinib (LOU064) in adult chronic spontaneous urticaria patients who completed the preceding remibrutinib Phase 3 studies)
Protocol code: CLOU064A2303B
Sponsor: Novartis Pharma AG (Pharmaceutical company). Phase: Therapeutic confirmatory (Phase III). Countries: Germany (ongoing, recruitment ended), Poland (ongoing, recruitment ended), Slovakia (ongoing, recruitment ended), Hungary (ongoing, recruitment ended), Italy (ended), Denmark (ended), Czechia (ended), Spain (ongoing, recruitment ended), France (ongoing, recruitment ended), Bulgaria (ongoing, recruitment ended).
Therapeutic area(s): Diseases [C] - Skin and Connective Tissue Diseases [C17]
Gender: Female, Male. Age: 18-64 years, 65+ years. Enrolment: 200.
Start date (EU): 2023-01-24. Decision date: 2024-08-21. Results received: No. Last updated: 2026-07-20.
Decision dates by country: DK: 2024-08-22, IT: 2024-09-09, ES: 2024-09-09, HU: 2024-08-27, SK: 2024-08-22, FR: 2024-09-02, BG: 2024-08-22, CZ: 2024-08-21, PL: 2024-08-30, DE: 2024-08-23

Condition(s): Chronic Spontaneous Urticaria
Product: LOU064, Placebo to remibrutinib (LOU064) 25 mg film-coated tablet

Primary endpoint: Time to first composite event (i.e., relapse (UAS7≥16), study treatment discontinuation due to lack of efficacy or intake of strongly confounding prohibited medication) during the randomized withdrawal period.
Endpoint(s): Safety endpoints will include but not be limited to: occurrence of treatment-emergent (serious and non-serious) adverse events during the extension study

Source: https://euclinicaltrials.eu/ctis-public/view/2024-510818-33-00